EU clinical trial 2024-514111-10-00: ARETHA: cARdiomems vEriciguaT Heart fAilure (A double-blind randomized placebo-controlled trial of vericiguat in heart failure patients with CardioMEMS™ HF System)
Sponsor: Rigshospitalet (Hospital/Clinic/Other health care facility). Phase: Therapeutic use (Phase IV). Countries: Denmark (ended).
Therapeutic area(s): Diseases [C] - Cardiovascular Diseases [C14]
Gender: Female, Male. Age: 18-64 years, 65+ years. Enrolment: 17.
Status: Ended. Start date (EU): 2024-12-06. End date (EU): 2026-03-17. Decision date: 2024-09-20. Results received: No. Last updated: 2025-04-16.

Condition(s): Heart failure with reduced ejection fraction (HFrEF)
Product: Verquvo 2.5 mg film-coated tablets, Verquvo 10 mg film-coated tablets, PLACEBO, Verquvo 5 mg film-coated tablets

Primary endpoint: To evaluate the diastolic pulmonary artery pressure (dPAP) lowering effect of vericiguat in comparison to placebo
Endpoint(s): To evaluate the NT-proBNP reducing effect of vericiguat compared with placebo

Source: https://euclinicaltrials.eu/ctis-public/view/2024-514111-10-00